EU clinical trial 2024-516661-37-00: A Phase 1b Open-Label, Clinical Trial to Evaluate the Safety, Tolerability, and Pharmacokinetics of ARV-110 in Combination with Abiraterone in Patients with Metastatic Prostate Cancer
Protocol code: ARV-110-mCRPC-103
Sponsor: Arvinas Androgen Receptor Inc. (Pharmaceutical company). Phase: Human Pharmacology (Phase I)- Other. Countries: France (ended).
Therapeutic area(s): Diseases [C] - Neoplasms [C04]
Gender: Male. Age: 18-64 years. Enrolment: 4.
Status: Ended. Start date (EU): 2022-07-27. End date (EU): 2024-12-10. End date: 2025-04-10. Decision date: 2024-10-29. Results received: No. Last updated: 2024-10-29.

Condition(s): Metastatic Prostate Cancer

Source: https://euclinicaltrials.eu/ctis-public/view/2024-516661-37-00